EU clinical trial 2024-514287-84-00: Danish non-inferiority study of ocrelizumab and rituximab in MS: A randomized study comparing the efficacy of ocrelizumab and rituximab in active multiple sclerosis
Protocol code: DanNORMS
Sponsor: Rigshospitalet (Hospital/Clinic/Other health care facility). Phase: Therapeutic confirmatory (Phase III). Countries: Denmark (ongoing, recruitment ended).
Therapeutic area(s): Diseases [C] - Nervous System Diseases [C10]
Gender: Female, Male. Age: 18-64 years, 65+ years. Enrolment: 600.
Status: Ongoing, recruitment ended. Start date (EU): 2021-04-28. Decision date: 2024-08-05. Results received: No. Last updated: 2026-04-09.

Condition(s): Multiple sclerosis
Product: Rixathon 500 mg concentrate for solution for infusion, Ocrevus 300 mg concentrate for solution for infusion, Ruxience 500 mg concentrate for solution for infusion

Primary endpoint: Percentage of patients with no new or enlarging T2 white matter lesions from month 6 to month 24
Endpoint(s): Percentage of patients with 6-month confirmed disease worsening (CDW) in EDSS from baseline to month 24 (m24) • ARR based on cumulative number of confirmed relapses from baseline to m24 • Percentage of patients with 6-months CDW in T25FW, 9HPT and SDMT from baseline to m24 • Change in MSIS-29, FSMC, EQ-5D from baseline to m24 • Percentage of patients without GdEL on m6 and m24 scans • Change in T2 and T1 white matter lesion volume from m6 to m24 • Difference in serum NFL from baseline to m24

Source: https://euclinicaltrials.eu/ctis-public/view/2024-514287-84-00